EU clinical trial 2026-525484-40-00: A Phase 1 Study of PRT12396 in Participants with Select Myeloproliferative Neoplasms
Protocol code: PRT12396-01
Sponsor: Prelude Therapeutics Inc. (Pharmaceutical company). Phase: Human Pharmacology (Phase I)- First administration to humans. Countries: Italy (authorised, recruitment pending), France (authorised, recruitment pending), Spain (authorised, recruitment pending).
Therapeutic area(s): Diseases [C] - Neoplasms [C04]
Gender: Female, Male. Age: 18-64 years, 65+ years. Enrolment: 22.
Status: Authorised, recruitment pending. Decision date: 2026-07-27. Results received: No. Last updated: 2026-07-30.
Decision dates by country: FR: 2026-07-27, IT: 2026-07-29, ES: 2026-07-30

Condition(s): Post-Essential Thrombocythemia Myelofibrosis, Post-Polycythemia Vera Myelofibrosis, Intermediate-1, Intermediate-2, or High-Risk Primary Myelofibrosis, High-risk Polycythemia Vera

Source: https://euclinicaltrials.eu/ctis-public/view/2026-525484-40-00